EU clinical trial 2024-517610-15-00: A Randomized, Double-blind, Placebo-controlled Study Evaluating the Effect of Allopurinol on the Risk of Cardiovascular Events in Patients With High and Very High Cardiovascular Risk, Including the Presence of Long-COVID Syndrome.
Protocol code: 2022/ABM/01/00027
Sponsor: Uniwersytet Medyczny Im. Karola Marcinkowskiego W Poznaniu (Educational Institution). Phase: Therapeutic confirmatory (Phase III). Countries: Poland (ongoing, recruiting).
Therapeutic area(s): Diseases [C] - Cardiovascular Diseases [C14]
Gender: Female, Male. Age: 18-64 years, 65+ years. Enrolment: 1116.
Status: Ongoing, recruiting. Start date (EU): 2024-03-28. Decision date: 2024-12-16. Results received: No. Last updated: 2025-12-03.

Condition(s): hyperuricemia, hypertension, ischemic stroke, intracerebral haemorrhage, TIA, heart failure, peripheral arterial disease, atrial fibrillation, diabetes mellitus
Product: Milurit, 200 mg, tabletki, Microcrystalline cellulose Magnesium stearate

Primary endpoint: Occurrence of a major cardiovascular event (MACE) such as all cause death, cardiac death, stroke/TIA, acute coronary syndrome, coronary artery angioplasty or revascularization, peripheral arterial angioplasty, hospitalization for unstable angina, or worsening heart failure (hospitalization and stay in the emergency room / Hospital Emergency Department due to heart failure, the need for intravenous loop diuretic and/or doubling the dose of oral loop diuretic).
Endpoint(s): Individual MACE components alone or in combination, Hospitalisation for reasons other than the primary endpoint., The assessment of the progression and/or development of organ complications and the development and/or progression of atherosclerosis including: echocardiography; the assessment of the incidence of atrial fibrillation in an electrocardiographic examination ; assessment of abdominal aorta diameter in uultrasound examination; the assessment of the intima-media complex and atherosclerotic plaques in the Doppler ultrasound of the carotid arteries; the assessment of the ankle-brachial index;, The occurrence of long-COVID-19 symptoms., The assessment of treatment efficacy: the attainment of target serum uric acid levels of 5 mg/dL or 5.5 mg/dL depending on baseline values., The assessment of other laboratory parameters: estimated glomerular filtration rate (eGFR), albumin-to-creatinine ratio, urinary albuminuria; HbA1c; lipid profile; plasma C reactive protein concentrations; activity of aspartate and alanine transaminases (AspAT, AlAT)., The assessment of the frequency of side effects., The assessment of changes in participants’ CVs based on the Systematic Coronary Risk Evaluation (SCORE) 2 scale

Source: https://euclinicaltrials.eu/ctis-public/view/2024-517610-15-00